EU clinical trial 2023-509975-17-00: An International, Phase 2, Open-Label, Randomized Study of BGB-3111 Combined With Obinutuzumab Compared With Obinutuzumab Monotherapy in Relapsed/ Refractory Follicular Lymphoma
Protocol code: BGB-3111-212
Sponsor: Beigene Ltd. (Pharmaceutical company). Phase: Therapeutic exploratory (Phase II). Countries: France (ended), Czechia (ended), Italy (ended), Spain (ended), Poland (ended).
Therapeutic area(s): Diseases [C] - Neoplasms [C04]
Gender: Female, Male. Age: 18-64 years, 65+ years. Enrolment: 97.
Status: Ended. Start date (EU): 2018-04-12. End date (EU): 2024-12-27. End date: 2024-12-28. Decision date: 2024-04-04. Results received: Yes. Last updated: 2024-07-22.
Decision dates by country: CZ: 2024-04-04, PL: 2024-04-08, ES: 2024-04-05, FR: 2024-04-05, IT: 2024-04-08

Condition(s): Relapsed/Refractory Follicular Lymphoma
Product: OBINUTUZUMAB, Zanubrutinib

Primary endpoint: The primary endpoint is overall response rate determined by independent central review using Lugano Classification for Non-Hodgkin Lymphoma (NHL), (modified from Cheson et al, 2014)., The overall response rate is defined as the proportion of patients who achieve either complete response or partial response as best overall response. Best overall response is defined as best response achieved during the entire follow-up period., However, for the patients in arm B who cross over to arm A, the disease assessment after the crossover will not be included in the derivation of best overall response.
Endpoint(s): Duration of response determined by independent central review and by investigator assessment, defined as the time from the date that response criteria are first met to the date that disease progression is objectively documented or death, whichever occurs first, Progression-free survival determined by independent central review and by investigator assessment, defined as the time from randomization to the date of first documentation of disease progression or death, whichever occurs first, Overall survival defined as the time from randomization to the date of death due to any reason., Rate of complete response or complete metabolic rate determined by independent central review and by investigator assessment, defined as the proportion of patients who achieve complete response or complete metabolic rate as best overall response, Time-to-response determined by independent central review and by investigator assessment, defined as the time from randomization to the time the response criteria are first met Patient-reported outcomes measured by EORTC QLQ-C30 and EQ-5D-5L questionnaires, Safety parameters, including AEs, SAEs, clinical laboratory tests, physical exams, and vital signs, PK parameters such as apparent clearance of the drug from plasma (CL/F) and AUC0-12

Source: https://euclinicaltrials.eu/ctis-public/view/2023-509975-17-00